EU clinical trial 2024-515757-24-00: A study to learn about how itraconazole affects the level of emodepside in the blood when emodepside is given as a new type of tablet to healthy participants
Protocol code: 22537
Sponsor: Bayer AG (Pharmaceutical company). Phase: Human Pharmacology (Phase I)- Other. Countries: Germany (ended).
Therapeutic area(s): Diseases [C] - Parasitic Diseases [C03]
Gender: Female, Male. Age: 18-64 years. Enrolment: 38.
Status: Ended. Start date (EU): 2025-02-04. End date (EU): 2025-04-30. Decision date: 2024-11-28. Results received: No. Last updated: 2025-01-14.

Condition(s): Soil-transmitted helminth infection, Onchocerciasis (river blindness)

Source: https://euclinicaltrials.eu/ctis-public/view/2024-515757-24-00